EU clinical trial 2024-511209-49-00: Combination of Abemaciclib and endocrine therapy in hormone receptor positive HER2 negative locally advanced or metastatic breast cancer with focus on digital side effect management The MINERVA Trial – A phase IV Trial
Sponsor: Universitaetsklinikum Ulm AöR (Hospital/Clinic/Other health care facility). Phase: Therapeutic use (Phase IV). Countries: Germany (ongoing, recruitment ended).
Therapeutic area(s): Diseases [C] - Neoplasms [C04]
Gender: Female. Age: 18-64 years, 65+ years. Enrolment: 285.
Status: Ongoing, recruitment ended. Start date (EU): 2022-04-26. Decision date: 2024-08-30. Results received: No. Last updated: 2026-07-09.

Condition(s): Patients with hormone receptor positive HER2 negative locally advanced or metastatic breast cancer
Product: Verzenios 150 mg film-coated tablets, FULVESTRANT, Verzenios 150 mg film-coated tablets, Verzenios 150 mg film-coated tablets, ANASTROZOLE, Verzenios 150 mg film-coated tablets, Verzenios 150 mg film-coated tablets, LETROZOLE, Verzenios 150 mg film-coated tablets, EXEMESTANE, Verzenios 150 mg film-coated tablets, Verzenios 150 mg film-coated tablets, Verzenios 150 mg film-coated tablets, Verzenios 150 mg film-coated tablets, Verzenios 150 mg film-coated tablets, Verzenios 150 mg film-coated tablets, Verzenios 150 mg film-coated tablets, Verzenios 150 mg film-coated tablets, Verzenios 150 mg film-coated tablets, Verzenios 150 mg film-coated tablets, Verzenios 150 mg film-coated tablets, Verzenios 150 mg film-coated tablets, Verzenios 150 mg film-coated tablets, Verzenios 150 mg film-coated tablets, Verzenios 150 mg film-coated tablets, Verzenios 150 mg film-coated tablets, Verzenios 150 mg film-coated tablets, Verzenios 150 mg film-coated tablets, Verzenios 150 mg film-coated tablets, Verzenios 150 mg film-coated tablets, Verzenios 150 mg film-coated tablets, Verzenios 150 mg film-coated tablets

Primary endpoint: The primary endpoint of this trial is progression-free survival (PFS). PFS time is measured from trial registration until the date of investigator-determined objective progression as defined by RECIST v1.1, or death from any cause. Patients who have neither progressed nor died will be censored at the day of their last radiographic tumor assessment, if available, or date of trial registration if no post-initiation (that is, post-baseline) radiographic assessment is available.
Endpoint(s): Overall Survival (OS), Objective Response Rate (ORR), Clinical Benefit Rate (CBR)

Source: https://euclinicaltrials.eu/ctis-public/view/2024-511209-49-00